EU clinical trial 2023-506741-34-00: A randomized, placebo-controlled, parallel-group, investigator- and participant-blinded Phase 2a study to investigate the efficacy, safety, and tolerability of DFV890 and MAS825 for inflammatory marker reduction in an adult population with coronary heart disease and Clonal Hematopoiesis of Indeterminate Potential (CHIP)
Protocol code: CADPT15A12201
Sponsor: Novartis Pharma AG (Pharmaceutical company). Phase: Therapeutic exploratory (Phase II). Countries: Germany (ended).
Therapeutic area(s): Diseases [C] - Cardiovascular Diseases [C14]
Gender: Female, Male. Age: 18-64 years, 65+ years. Enrolment: 16.
Status: Ended. Start date (EU): 2024-02-16. End date (EU): 2024-11-04. End date: 2024-11-05. Decision date: 2024-02-08. Results received: Yes. Last updated: 2024-10-25.
Decision dates by country: DE: 2024-04-24

Condition(s): Atherosclerotic cardiovascular disease
Product: DFV890, DFV890, Placebo to MAS825 100 mg/1 mL Solution for Injection, Placebo to DFV890 10 mg and 25 mg film-coated tablet, MAS825

Primary endpoint: Serum levels of IL-6 and IL-18 at 3 weeks after the start of a DFV890 dosing period, Serum level of IL-6 at 3 weeks after a single s.c. dose of MAS825
Endpoint(s): Adverse events, and parameters from safety assessments, including vital signs, electrocardiograms (ECGs), and laboratory assessments (urine and blood), Plasma trough concentrations (Ctrough) of DFV890 at steady-state, Serum concentrations of MAS825 after a single s.c. dose of MAS825

Source: https://euclinicaltrials.eu/ctis-public/view/2023-506741-34-00